EU clinical trial 2022-503070-36-00: C1091009 - A PHASE 3, RANDOMIZED, PLACEBO-CONTROLLED, DOUBLE-BLINDED TRIAL TO EVALUATE THE SAFETY, TOLERABILITY, AND IMMUNOGENICITY OF A MULTIVALENT GROUP B STREPTOCOCCUS VACCINE IN HEALTHY PREGNANT WOMEN AND THEIR INFANTS
Protocol code: C1091009
Sponsor: Pfizer Inc. (Pharmaceutical company). Phase: Therapeutic confirmatory (Phase III). Countries: Finland (ongoing, recruiting), Netherlands (ongoing, recruiting), Spain (ongoing, recruiting).
Therapeutic area(s): Diseases [C] - Bacterial Infections and Mycoses [C01]
Gender: Female, Male. Age: In utero, 0-17 years, 18-64 years. Enrolment: 764.
Status: Ongoing, recruiting. Start date (EU): 2025-12-23. Decision date: 2025-11-18. Results received: No. Last updated: 2026-08-04.
Decision dates by country: ES: 2025-11-19, NL: 2025-11-19, FI: 2025-11-18

Condition(s): Group B streptococcus (GBS) disease
Product: Placebo to Group B Streptococcus 6-Valent Polysaccharide Conjugate Vaccine (GBS6), Group B Streptococcus 6-Valent Polysaccharide Conjugate Vaccine (GBS6)

Primary endpoint: Prespecified local reactions (redness, swelling, and pain at the injection site)., Prespecified systemic events (fever, nausea, vomiting, diarrhea, headache, fatigue, muscle pain, and joint pain)., Adverse events (AEs)., Serious adverse events (SAEs)., Medically attended adverse events (MAAEs)., GBS serotype specific anti-CPS IgG antibody concentrations measured at birth in infant participants, Adverse events of special interest (AESIs).
Endpoint(s): GBS serotype-specific anti-CPS IgG antibody concentrations in infant participants, GBS serotype-specific OPA antibody titers in infant participants, GBS serotype-specific anti-CPS IgG antibody concentrations measured at birth in infant participants, GBS serotype-specific anti-CPS IgG antibody concentrations in maternal participants, Serum IgG concentration to diphtheria toxoid in a subset of infant participants. Serum IgG concentration to PCV serotypes in a subset of infant participants

Source: https://euclinicaltrials.eu/ctis-public/view/2022-503070-36-00